EU clinical trial 2024-516289-12-00: A Phase 1/2, Open-Label, Multicenter Study to Investigate the Safety, Pharmacokinetics, and Efficacy of Fadraciclib (CYC065), an Oral CDK2/9 Inhibitor, in Subjects with Advanced Solid Tumors and Lymphoma.
Protocol code: CYC065-101
Sponsor: Cyclacel Limited (Pharmaceutical company). Phase: Phase I and Phase II (Integrated)- Other. Countries: Spain (ended).
Therapeutic area(s): Diseases [C] - Neoplasms [C04]
Gender: Female, Male. Age: 18-64 years, 65+ years. Enrolment: 30.
Status: Ended. Start date (EU): 2022-02-24. End date (EU): 2025-01-07. Decision date: 2024-08-06. Results received: No. Last updated: 2024-12-30.

Condition(s): Endometrial cancer, Ovarian cancer, Biliary tract cancer, Hepatocellular carcinoma, B-cell lymphoma, T-cell lymphoma, Metastatic colorectal cancer, Breast cancer (metastatic HER-2 refractory, Hormone receptor +, HER-2 negative, and MBC post-CDK4/6 inhibitor, Triple-negative) Basket cohort: tumor types that are suspected to have a related mechanism of action and are not included in previous groups

Primary endpoint: Phase 1: The incidence rate of dose-limiting toxicities (first cycle only) at each dose level. Phase 2: ORR according to Response Evaluation Criteria in Solid Tumors: RECIST guidelines (Lugano Criteria for lymphoma, mSWAT for CTCL) for each tumor type
Endpoint(s): Safety, Disease control rate (DCR), Response rate as per Lugano Criteria for lymphoma, mSWAT for CTCL, Progression-free survival, Duration of response, Overall survival, PK in Phase 1

Source: https://euclinicaltrials.eu/ctis-public/view/2024-516289-12-00